EU clinical trial 2023-505889-29-01: Trial evaluating the efficacy and the safety of FOLFIRINOX3 treatment in patients with unresectable locally advanced or metastatic pancreatic cancer in first line of chemotherapy
Protocol code: FOLFIRINOX3_PANCREAS
Sponsor: Centr Georges Francois Leclerc (Hospital/Clinic/Other health care facility). Phase: Therapeutic exploratory (Phase II). Countries: France (ongoing, recruiting).
Therapeutic area(s): Diseases [C] - Neoplasms [C04]
Gender: Female, Male. Age: 18-64 years, 65+ years. Enrolment: 90.
Status: Ongoing, recruiting. Start date (EU): 2024-02-01. Decision date: 2023-10-03. Results received: No. Last updated: 2023-10-03.

Condition(s): Patients with unresectable locally advanced or metastatic pancreatic cancer in first line of chemotherapy

Source: https://euclinicaltrials.eu/ctis-public/view/2023-505889-29-01